EU clinical trial 2024-514873-22-00: MULTISARC : MOLECULAR PROFILING OF ADVANCED SOFT-TISSUE SARCOMAS. A phase III study
Protocol code: C16-40
Sponsor: Institut National De La Sante Et De La Recherche Medicale (Laboratory/Research/Testing facility). Phase: Therapeutic confirmatory (Phase III). Countries: France (ended).
Therapeutic area(s): Diseases [C] - Neoplasms [C04]
Gender: Female, Male. Age: 18-64 years, 65+ years. Enrolment: 960.
Status: Ended. Start date (EU): 2019-10-16. End date (EU): 2026-01-20. Decision date: 2024-10-03. Results received: No. Last updated: 2025-11-26.

Condition(s): Unresectable locally advanced and/or metastatic soft-tissue sarcoma
Product: Lynparza 150 mg film-coated tablets, IBRANCE 125 mg hard capsules, Lynparza 100 mg film-coated tablets, IMFINZI 50 mg/mL concentrate for solution for infusion., Tabrecta 200 mg film-coated tablets, Daurismo 100 mg film-coated tablets, Mekinist 0.5 mg film-coated tablets, Tabrecta 150 mg film-coated tablets, Lytgobi 4 mg film-coated tablets, Mekinist 2 mg film-coated tablets, IBRANCE 100 mg hard capsules, Tyverb 250 mg film-coated tablets, Tafinlar 75 mg hard capsules, Zykadia 150 mg hard capsules, IBRANCE 75 mg hard capsules, Daurismo 25 mg film-coated tablets, Tasigna 200 mg hard capsules, Futibatinib, Tafinlar 50 mg hard capsules

Primary endpoint: Feasibility next generation sequencing exome : NGS (exome) for the primary objective will be considered feasible if (i) NGS results are available and interpretable, and (ii) a report of exome sequencing including a clinical recommendation from a molecular tumor board is provided to investigators within 7 weeks (i.e. at most 49 calendar days) from reception of the samples (blood and tumor samples) by one of the MULTIPLI platforms.
Endpoint(s): Overall survival (OS): OS for the secondary objective is defined as the delay from the date of randomization to the date of death. OS for the assessment of efficacy of first-line treatment: OS will be defined as the delay from the date of onset of first-line treatment to the date of death. OS for the assessment of efficacy of targeted treatment: OS will be defined as the delay from the date of onset of targeted treatment to the date of death., Progression-free survival (PFS) for the secondary objective is defined as the delay from the date of randomization to the date of progression as per RECIST v1.1. or death, whichever occurs first. PFS for the assessment of efficacy of first-line treatment and the targeted treatment: PFS will be defined as the delay from the date of onset of first-line or targeted treatment to the date of progression as per RECIST v1.1. or death, whichever occurs first., Participants with targetable alteration(s) A participant will be considered as “presenting at least one targetable genomic alteration”, if the MTB consider that at least one genomic alteration identified can be matched with one of the drug available through the MULTISARC study., Best overall response for the assessment of efficacy of first-line treatment: Best response will be recorded from the date of onset of first-line treatment taking into account any requirement for confirmation as per RECIST 1.1 criteria. Best overall response under treatment for the assessment of efficacy of targeted treatment: Best response will be recorded from the date of onset of targeted treatment taking into account any requirement for confirmation as per RECIST 1.1 criteria., Objective response under treatment is defined as complete or partial response (CR, PR) as per RECIST v1.1 under first-line treatment. ). Following RECIST v1.1 recommendations, each participant will be assigned one of the following categories: complete response, partial response, stable disease, progression, invaluable for response. Moreover, claimed responses will have to be confirmed at least 4 weeks later to ensure responses identified are not the result of measurement errors., For the assessment of efficacy of first-line treatment and targeted treatment: Non-progression at 6 months is defined as complete or partial response (CR, PR) or stable disease (SD) at 6 months as per RECIST v1.1 under first-line or targeted treatment. Claimed responses will have to be confirmed at least 4 weeks later to ensure responses identified are not the result of measurement errors., Change in tumor size is defined as the difference (in percentage) in tumor size burden from the date of targeted treatment initiation (baseline) to the tumor assessment., Immunosequencing: Correlation of TCR-sequencing data with objective response (OR), progression-free survival (PFS) and Evaluate the association between immune profiles derived from ancillary analyses (VISIUM HD, multiplex IF, SomaScan proteomics) and treatment response, within an integrated immunosequencing framework. and overall survival (OS)., Real cost of NGS: Micro-costing studies collect detailed data on resources utilized and the value of those resources. Cost of other resources: The French National Health Insurance reimburses the vast majority of other resources involved in the care of patients in this trial. These costs will be extracted from the French National Health Insurance data, and cost Per diem allowances: In case of sick leave., Utility data and Quality Adjusted Life Years Utility scores will be assessed through the EuroQol-5D-5L questionnaire. A Quality Adjusted Life Year is the survival (in years) weighted by a utility score., Incremental cost utility ratio: Our incremental cost-utility ratio is difference in cost between both strategies (NGS and no NGS) divided by the difference in QALYs.

Source: https://euclinicaltrials.eu/ctis-public/view/2024-514873-22-00